EU clinical trial 2024-515341-41-01: COLLISION RELAPSE trial Recurrent colorectal liver metastases: repeat local treatment +/- neoadjuvant systemic therapy, a phase III prospective randomized controlled trial
Sponsor: Stichting Amsterdam UMC (Hospital/Clinic/Other health care facility). Phase: Phase III and phase IV (Integrated). Countries: Netherlands (ongoing, recruiting).
Therapeutic area(s): Diseases [C] - Neoplasms [C04]; Diseases [C] - Digestive System Diseases [C06]
Gender: Female, Male. Age: 18-64 years, 65+ years. Enrolment: 360.
Status: Ongoing, recruiting. Start date (EU): 2024-12-11. Decision date: 2024-12-11. Results received: No. Last updated: 2024-12-11.

Condition(s): Colorectal liver metastases
Product: Leucovorine Sandoz 15 mg, capsules, Fluorouracil Accord 50 mg/ml otopina za injekciju/infuziju, Capecitabine Accord 150 mg film-coated tablets, Oxaliplatine Accord 5 mg/ml concentraat voor oplossing voor infusie, Irinotecan Accordpharma 20 mg/ml koncentrát pro infuzní roztok

Primary endpoint: Primary objective is to compare overall survival (OS) in both study arms, counting from the date of randomization to the date of death of the patient or to the last day of follow-up (censored)
Endpoint(s): Distant progression free survival (DPFS; per patient analysis): Overall DPFS is defined as the time from randomization to the time of disease progression (according to the RECIST 1.1 guideline (205)) or cancer related death (events), death related to other causes is considered a competing risk, Local tumor progression free survival (LTPFS; per tumor and per patient analysis): Overall LTPFS is defined as the time from randomization to the time of local disease progression, new metastases (events), censoring the date of death from any cause (competing risk), completion ablations performed within 6 weeks for residual tumor are not considered events for the local tumor progression analysis, Rate of adverse events and serious adverse events (AE and SAE; per procedure analysis), associated with both treatment arms; o Systemic therapy related toxicity is graded from 1 to 5 according to the CTCAE version 5.0, discussed in paragraph 9.4; o Procedural morbidity and mortality are graded from I to V according to the standard classification of surgical complications (206), discussed in paragraph 9.4, Length of hospital stay, Pain assessment using visual analogue scale questionnaires (VAS; per procedure analysis: Assessed prior to, directly after and every three months after local treatment, To determine quality of life in both treatment arms. Quality of life assessment using EORCT QLQ-C30, EQ-5D, and PRODISQ questionnaires (per procedure analysis): Assessed prior to, and Version 3 May 12th 2023 31 of 140 every three months after local treatment, assessed prior to, during and after neoadjuvant systemic therapy, Direct and indirect total costs of care per treatment arm, quality-adjusted life years (QALY) and incremental cost-effectiveness ratio (ICER) per treatment arm (per patient analysis)

Source: https://euclinicaltrials.eu/ctis-public/view/2024-515341-41-01